EU clinical trial 2024-516573-71-00: A Randomized, Double Blind, Placebo Controlled, Crossover Trial of Clebopride vs Placebo in the Treatment of Clinically Suspected Rumination Syndrome.
Sponsor: UZ Leuven (Hospital/Clinic/Other health care facility). Phase: Therapeutic use (Phase IV). Countries: Belgium (ongoing, recruiting).
Therapeutic area(s): Phenomena and Processes [G] - Digestive System and Oral Physiological Phenomena [G10]
Gender: Female, Male. Age: 18-64 years. Enrolment: 20.
Status: Ongoing, recruiting. Start date (EU): 2019-10-03. Decision date: 2024-10-29. Results received: No. Last updated: 2024-10-29.

Condition(s): Rumination Syndrome
Product: Placebo tablet manufactured by Laboratoria Wolfs, ingredients per tablet (488mg): Lactose monohydrate 320mg/tablet; Carmellose sodium 10mg/tablet; Corn starch 70mg/tablet; Cellulose microcrystalline 55mg/tablet; Silicium dioxide anhydrous 20mg/tablet; Magnesium stearate 13mg/tablet, MOTILEX 0,5 mg compresse

Primary endpoint: The patients perceived overall treatment evaluation (OTE), which will be obtained using a Likert score between -4 and +4.
Endpoint(s): The overall symptom severity (OSS) compared between both treatment periods . The OSS will be filled out at the end of each treatment period, and numbers will be compared between the two treatment periods., The difference between receiving clebopride and placebo in the number of symptom events identified by the patient during HRiM. Patients will have to push a symptom marker during the HRiM measurement. Different markers will be used for different symptoms, Number of flow events during HRiM., EGJ pressure during HRiM. The averages after a meal period will be compared between placebo and clebopride condition, Number of TLESRs. The number of TLESRs will be compared between placebo and clebopride condition, Number of events with increased Intra-gastric pressure, Daily Symptom Diary Leuven Postprandial Distress Scale (LPDS) diary with additional question concerning retrograde bolus flow, Symptom severity at week 2 (PAGI-SYM), Quality of life at week 2 (PAGI-QOL)

Source: https://euclinicaltrials.eu/ctis-public/view/2024-516573-71-00